EU clinical trial 2025-522700-24-00: RANDOMISED CLINICAL STUDY TO ASSESS THE EFFICACY AND SAFETY OF PLATELET-RICH PLASMA (PRP) INFILTRATION COMBINED WITH PHYSICAL EXERCISE IN CHRONIC OMALGIA
Protocol code: SHIELD-PRP
Sponsor: Asociacion Instituto De Investigacion Sanitaria Biobizkaia (Laboratory/Research/Testing facility). Phase: Therapeutic confirmatory (Phase III). Countries: Spain (ongoing, recruiting).
Therapeutic area(s): Diseases [C] - Musculoskeletal Diseases [C05]
Gender: Female, Male. Age: 18-64 years, 65+ years. Enrolment: 86.
Status: Ongoing, recruiting. Start date (EU): 2026-01-13. Decision date: 2025-10-20. Results received: No. Last updated: 2026-07-06.

Condition(s): CHRONIC OMALGIA
Product: Ropivacaína Altan 7,5 mg/ml solución inyectable EFG, PLATELET CONCENTRATE, Celestone Cronodose suspensión inyectable

Primary endpoint: The difference in functional improvement between the intervention group (PRP infiltration combined with physical exercise) and the control group (corticosteroid infiltration combined with physical exercise), measured by the absolute change in the Constant-Murley scale (CMS) score at 6 months post-treatment, compared to the baseline score (14). An increase ≥ 10 points in the CMS score (15), in the absence of serious treatment-related complications, is considered a therapeutic success.

Source: https://euclinicaltrials.eu/ctis-public/view/2025-522700-24-00